EU clinical trial 2023-503501-11-00: An Open-label, Multicenter, Phase 3 Randomized, Active-Comparator- Controlled Clinical Study of Pembrolizumab (MK-3475) in Combination With Sacituzumab Govitecan Versus MK-3475 Monotherapy as First-line Treatment in Participants With PD L1 TPS Greater than or Equal to 50% Metastatic Non-small Cell Lung Cancer (KEYNOTED46/EVOKE-03)
Protocol code: MK-3475-D46
Sponsor: Merck Sharp & Dohme LLC (Pharmaceutical company). Phase: Therapeutic confirmatory (Phase III). Countries: Greece (ongoing, recruitment ended), Estonia (ended), Latvia (ongoing, recruitment ended), Romania (ongoing, recruitment ended), Germany (ongoing, recruitment ended), Italy (ongoing, recruitment ended), Lithuania (ongoing, recruitment ended), Poland (ongoing, recruitment ended).
Therapeutic area(s): Diseases [C] - Neoplasms [C04]
Gender: Female, Male. Age: 18-64 years, 65+ years. Enrolment: 153.
Start date (EU): 2023-02-09. Decision date: 2023-10-20. Results received: No. Last updated: 2026-05-11.
Decision dates by country: EE: 2023-10-23, GR: 2023-10-30, PL: 2023-11-27, LT: 2023-10-27, RO: 2023-10-25, LV: 2023-10-23, IT: 2023-10-24, DE: 2023-10-20

Condition(s): Metastatic Non-small Cell Lung Cancer
Product: KEYTRUDA 25 mg/mL concentrate for solution for infusion, SACITUZUMAB GOVITECAN

Primary endpoint: Progression-Free Survival (PFS), Overall Survival (OS)
Endpoint(s): Objective Response (OR), Duration of Response (DOR), Change from Baseline in the Global Health Status/Quality of Life (Items 29 and 30) Combined Score on the European Organization for Research and Treatment of Cancer Quality of Life Questionnaire - Core 30 (EORTC QLQ-C30, Change from Baseline in Physical Functioning (Items 1-5) Combined Score on the EORTC QLQ-C30, Change from Baseline in Role Functioning (Items 6-7) Combined Score on the EORTC QLQ-C30, Change from Baseline in Dyspnea Score (Item 8) on the EORTC QLQ-C30, Change from Baseline in Cough Score (Item 31) on the European Organization for Research and Treatment of Cancer Quality of Life Questionnaire - Lung Cancer 13 (EORTC QLQ-LC13), Change from Baseline in Chest Pain Score (Item 40) on the EORTC QLQ-LC13, Time to Deterioration (TTD) in the Global Health Status/Quality of Life (Items 29 and 30) Combined Score on the EORTC QLQ-C30, TTD in Physical Functioning (Items 1-5) Combined Score on the EORTC QLQ-C30, TTD in Role Functioning (Items 6-7) Combined Score on the EORTC QLQ-C30, TTD in Dyspnea Score (Item 8) on the EORTC QLQ-C30, TTD in Cough Score (Item 31) on the EORTC QLQ-LC13, TTD in in Chest Pain Score (Item 40) on the EORTC QLQ-LC13, Number of Participants Who Experience an Adverse Event (AE), Number of Participants Who Discontinue Study Treatment Due to an AE

Source: https://euclinicaltrials.eu/ctis-public/view/2023-503501-11-00